EU clinical trial 2023-504215-32-00: A Phase I/II, Randomised, Single-blind, Placebo-controlled, Multiple-ascending-dose Study to Evaluate the Safety, Tolerability, Pharmacokinetics, and Pharmacodynamics of AZD9550 Monotherapy and Co-administration of AZD9550 and AZD6234 in Participants Living with Obesity and Overweight with or without Type 2 Diabetes Mellitus
Protocol code: D8460C00002
Sponsor: AstraZeneca AB (Pharmaceutical company). Phase: Phase I and Phase II (Integrated)- Other. Countries: Germany (temporarily halted), Sweden (ended), Austria (ended).
Therapeutic area(s): Diseases [C] - Nutritional and Metabolic Diseases [C18]
Gender: Female, Male. Age: 18-64 years, 65+ years. Enrolment: 108.
Start date (EU): 2023-09-28. Decision date: 2023-09-12. Results received: No. Last updated: 2026-04-15.
Decision dates by country: AT: 2023-09-18, SE: 2023-09-13, DE: 2023-09-12

Condition(s): Overweight and obesity
Product: CALCIUM CARBONATE, DAPAGLIFLOZIN, AZD6234, Placebo to match AZD9550, ONDANSETRON, GLUCAGON, CALCIUM CITRATE, CALCIUM GLUCONATE, Placebo to match AZD6234, CYCLIZINE, METFORMIN, GLUCOSE

Primary endpoint: Parts A, B, C: • AEs and SAEs • Vital signs • ECG • Clinical laboratory assessments, Part A: • PK parameters (AUClast, AUCtau, Cmax, t1/2λz, tmax, CL/F, Vz/F, and other PK parameters if applicable) at first dose and last dose (at the same dose level) • Rac (AUCtau and Cmax), Part E: • AEs, SAEs, and AESIs • Vital signs • ECG • Clinical laboratory assessments, Part F: • "CCI" • AEs and SAEs • Vital signs • ECG • Clinical laboratory assessments
Endpoint(s): Part A • Absolute change from baseline to Week 4 in fasting glucose, fasting insulin, fasting c-peptide, and HbA1c • Percent change from baseline to Week 4 in fasting glucose, fasting insulin, fasting c-peptide, and HbA1c, Part A • Absolute and percentage change from baseline to Week 4 in total cholesterol, high-density lipoprotein, low-density lipoprotein, triglycerides, and ..., Part A • Absolute change from baseline to Week 4 in body weight • Percentage change from baseline to Week 4 in body weight • Absolute change from baseline to Week 4 in percentage body fat, Part A • Incidence and titre of ADA to AZD9550, Part B • Absolute change from baseline to Week 5 in fasting glucose, fasting insulin, fasting c-peptide and HbA1c • Percent change from baseline to Week 5 in fasting glucose, fasting insulin, fasting c-peptide and HbA1c, Part B • Absolute and percentage change from baseline to Week 5 in total cholesterol, high-density lipoprotein, low-density lipoprotein, triglyceride, and ..., Part B • Change from baseline to Week 5 in hepatic fat fraction as measured by MRI-PDFF • Percent change from baseline to Week 5 in hepatic fat fraction as measured by MRI-PDFF, Part B • Absolute change from baseline to Week 5 in body weight • Percent change from baseline to Week 5 in body weight • Proportion of participants achieving ≥ 5% body weight loss from baseline to Week 5 • Proportion of participants achieving ≥ 10% body weight loss from baseline to Week 5 • Absolute change from baseline to Week 5 in percentage body fat, Part B • Percent change from baseline to Week 5 in glucose AUC(0-4h) measured by MMTT • Percent change from baseline to Week 5 in insulin AUC(0-4h) measured by MMTT • Percent change from baseline to Week 5 in c-peptide AUC(0-4h) measured by MMTT • Absolute change from baseline to Week 5 in fasting glucose, fasting insulin, and fasting c-peptide • Percent change from baseline to Week 5 in fasting glucose, fasting insulin, and fasting c-peptide, Part B • PK parameters (AUClast, AUCtau, Cmax, t1/2λz, tmax, CL/F, Vz/F, and other PK parameters if applicable) at the last dose, Part B • Incidence and titre of ADA to AZD9550, Part C • Absolute change from baseline to Week 24 in fasting glucose, fasting insulin, fasting c-peptide, and HbA1c • Percent change from baseline to Week 24 in fasting glucose, fasting insulin, fasting c-peptide, and HbA1c, Part C • Absolute and percentage change from baseline to Week 24 in total cholesterol, high-density lipoprotein, low-density lipoprotein, triglycerides, and ..., Part C • Change from baseline to Weeks 13 and 24 in hepatic fat fraction as measured by MRI-PDFF • Percent change from baseline to Weeks 13 and 24 in hepatic fat fraction as measured by MRI-PDFF, Part C • Change from baseline to Week 24 in body weight • Percent change from baseline to Week 24 in body weight • Proportion of participants achieving ≥ 5% body weight loss from baseline to Week 24 • Proportion of participants achieving ≥ 10% body weight loss from baseline to Week 24 • Absolute change from baseline to Week 24 in percentage body fat, Part C • PK parameters (AUClast, AUCtau, Cmax, t1/2λz, tmax, CL/F, Vz/F, and other PK parameters if applicable) at the first doses of 00 mg, 00 mg, 00 mg and the last dose of MTD, Part C • Incidence and titre of ADA to AZD9550, Part B • Change in daily (24 hours) average glucose levels as measured by CGM from baseline to Weeks 1, 2, 3, 4, 5, and 6 • Change in 7-day average glucose levels as measured by CGM from baseline to Weeks 1, 2, 3, 4, 5, and 6 • Change in coefficient of variation of glucose levels as measured by CGM over 7 days from baseline to Weeks 1, 2, 3, 4, 5, and 6, Part B • Change in percentage time spent in hyperglycaemia (> 140 mg/dL), normoglycaemia (70 –140 mg/dL), and clinically significant hypoglycaemia (< 54 mg/dL) as measured by CGM over 24 hours from baseline to Weeks 1, 2, 3, 4, 5, and 6• Change in percentage time spent in hyperglycaemia (> 140 mg/dL), normoglycaemia (70 –140 mg/dL), and clinically significant hypoglycaemia (< 54 mg/dL) as measured by CGM over 7 days from baseline to Weeks 1, 2, 3, 4, 5, and 6., Part B • Change from baseline to Week 5 in fasting hepatic glycogen concentration adjusted for liver volume as measured by MRS • Percentage change from baseline to Week 5 in fasting hepatic glycogen concentration adjusted for liver volume as measured by MRS • Change from baseline to Week 5 in fasting hepatic glycogen concentration unadjusted for liver volume as measured by MRS, Part B • Percentage change from baseline to Week 5 in fasting hepatic glycogen concentration unadjusted for liver volume as measured by MRS • Change in liver volume, visceral and subcutaneous fat as measured by MRI from baseline to Week 5, Part C • Change in daily (24 hours) average glucose levels as measured by CGM from baseline to each week of the treatment period, and during 14 days post last dose • Change in 7-day average glucose levels as measured by CGM from baseline to each week of the treatment period and during 14 days post last dose, Part C • Change in coefficient of variation of glucose levels as measured by CGM over 7 days from baseline to each week of the treatment period and during 14 days post last dose • Change in percentage time spent in hyperglycaemia (> 140 mg/dL), normoglycaemia (70 –140 mg/dL), and clinically significant hypoglycaemia (< 54 mg/dL) as measured by CGM over 24 hours from baseline to each week of the treatment period and during 14 days post last dose, Part C • Change in percentage time spent in hyperglycaemia (> 140 mg/dL), normoglycaemia (70 –140 mg/dL), and clinically significant hypoglycaemia (< 54 mg/dL) as measured by CGM over 7 days from baseline to each week of the treatment period and during 14 post last dose, Part C • Change from baseline to Weeks 13 and 24 in fasting hepatic glycogen concentration adjusted for liver volume as measured by MRS • Percentage change from baseline to Weeks 13 and 24 in fasting hepatic glycogen concentration adjusted for liver volume as measured by MRS • Change from baseline to Weeks 13 and 24 in fasting hepatic glycogen concentration unadjusted for liver volume as measured by MRS, Part C • Percentage change from baseline to Weeks 13 and 24 in fasting hepatic glycogen concentration unadjusted for liver volume as measured by MRS • Change in liver volume, visceral and SC fat as measured by MRI from baseline to Weeks 13 and 24, Part A • Change in daily (24 hours) average glucose levels as measured by CGM from baseline to Weeks 1, 2, 3, 4, 5, and 6 • Change in 7-day average glucose levels as measured by CGM from baseline to Weeks 1, 2, 3, 4, 5, and 6 • Change in coefficient of variation of glucose levels as measured by CGM over 7 days from baseline to Weeks 1, 2, 3, 4, 5, and 6, Part A • Change in percentage time spent in hyperglycaemia (> 140 mg/dL), normoglycaemia (70 –140 mg/dL), and clinically significant hypoglycaemia (< 54 mg/dL) as measured by CGM over 24 hours from baseline to Weeks 1, 2, 3, 4, 5, and 6 • Change in percentage time spent in hyperglycaemia (> 140 mg/dL), normoglycaemia (70 –140 mg/dL), and clinically significant hypoglycaemia (< 54 mg/dL) as measured by CGM over 7 days from baseline to Weeks 1, 2, 3, 4, 5, and 6., Part C • Percent change from baseline to Week 13 and Week 24 in glucose AUC(0-4h) measured by MMTT • Percent change from baseline to Week 13 and Week 24 in insulin AUC(0-4h) measured by MMTT • Percent change from baseline to Week 13 and Week 24 in c-peptide AUC(0-4h) measured by MMTT, Part C • Absolute change from baseline to Week 13 and Week 24 in fasting glucose, fasting insulin, and fasting c-peptide • Percent change from baseline to Week 13 and Week 24 in fasting glucose, fasting insulin, and fasting c-peptide, Part E: • Prevalence, incidence, and titres of ADAs to AZD9550 and AZD6234 in combination after 24 weeks of treatment, Part F: Change from baseline to Week 29 in body weight • Percent change from baseline to Week 29 in body weight • Proportion of participants achieving ≥ 5% body weight loss from baseline to Week 29 • Proportion of participants achieving ≥ 10% body weight loss from baseline to Week 29, Part F: • Incidence and titre of ADA to AZD9550

Source: https://euclinicaltrials.eu/ctis-public/view/2023-504215-32-00